EU clinical trial 2023-503631-18-01: An interventional, Phase 3 extension study to investigate long-term safety and tolerability of tolebrutinib in participants with relapsing multiple sclerosis, primary progressive multiple sclerosis, or nonrelapsing secondary progressive multiple sclerosis
Protocol code: LTS17043
Sponsor: Sanofi-Aventis Recherche & Developpement (Pharmaceutical company). Phase: Therapeutic confirmatory (Phase III). Countries: Sweden (ongoing, recruiting), Croatia (ongoing, recruiting), Norway (ongoing, recruiting), Slovakia (ongoing, recruitment ended), France (ongoing, recruiting), Lithuania (ongoing, recruitment ended), Finland (ongoing, recruitment ended), Poland (ongoing, recruiting), Romania (ongoing, recruiting), Netherlands (ongoing, recruiting), Hungary (ongoing, recruiting), Italy (ongoing, recruiting), Austria (ongoing, recruiting), Czechia (ongoing, recruiting), Belgium (ongoing, recruiting), Germany (ongoing, recruiting), Latvia (ongoing, recruitment ended), Denmark (ongoing, recruiting), Estonia (ongoing, recruiting), Greece (ongoing, recruiting), Spain (ongoing, recruiting), Bulgaria (ongoing, recruiting), Portugal (ongoing, recruiting).
Therapeutic area(s): Diseases [C] - Nervous System Diseases [C10]
Gender: Female, Male. Age: 18-64 years, 65+ years. Enrolment: 1405.
Start date (EU): 2024-05-20. Decision date: 2024-05-06. Results received: No. Last updated: 2026-07-23.
Decision dates by country: BG: 2024-05-13, DK: 2024-05-07, CZ: 2024-05-07, DE: 2024-05-08, SE: 2024-05-13, LT: 2024-05-08, BE: 2024-05-07, FR: 2024-05-14, LV: 2024-05-10, NO: 2024-05-08, EE: 2024-05-09, PL: 2024-05-07, AT: 2024-05-10, RO: 2024-05-13, IT: 2024-05-09, GR: 2024-05-13, PT: 2024-05-10, SK: 2024-05-10, FI: 2024-05-10, HR: 2024-05-07, HU: 2024-05-13, NL: 2024-05-06, ES: 2024-05-07

Condition(s): Nervous system diseases
Product: Matched Placebo for Comparator Teriflunomide, AUBAGIO 14 mg film-coated tablets, Tolebrutinib, COLESTYRAMINE, Matched Placebo to Test

Primary endpoint: Number of Participants with Adverse Events (AEs), Serious Adverse Events (SAEs), Adverse Events of Special Interest (AESIs) and AEs leading to permanent study intervention discontinuation, Number of Participants with Potentially clinically significant abnormalities (PCSAs
Endpoint(s): Time to onset of 6-month confirmed disability worsening (CDW for RMS) or confirmed disability progression (CDP for PPMS and NRSPMS) for participants from pivotal studies, Annualized Relapse Rate (ARR) for RMS only, Number of new and/or enlarging T2-hyperintense lesions per year, Change from baseline in total volume of T2-hyperintense lesions, ToleDYNAMIC substudy Change from baseline in biomarkers

Source: https://euclinicaltrials.eu/ctis-public/view/2023-503631-18-01